EU clinical trial 2023-510061-10-00: A Dose-Escalation and Expansion Study of the Safety and Efficacy of XL092 in Combination with Immuno-Oncology Agents in Subjects with Unresectable Advanced or Metastatic Solid Tumors
Protocol code: XL092-002
Sponsor: Exelixis Inc. (Pharmaceutical company). Phase: Human Pharmacology (Phase I)- Other. Countries: Poland (ongoing, recruiting), Spain (ongoing, recruiting), Germany (ongoing, recruiting), Italy (ongoing, recruiting), Austria (ongoing, recruiting), France (ongoing, recruiting), Belgium (ongoing, recruiting).
Therapeutic area(s): Diseases [C] - Neoplasms [C04]
Gender: Female, Male. Age: 18-64 years, 65+ years. Enrolment: 290.
Status: Ongoing, recruiting. Start date (EU): 2023-01-09. Decision date: 2024-03-28. Results received: No. Last updated: 2026-06-03.
Decision dates by country: ES: 2024-04-02, AT: 2024-04-08, PL: 2024-03-28, BE: 2024-04-02, DE: 2024-04-02, FR: 2024-04-03, IT: 2024-04-02

Condition(s): Clear cell renal cell carcinoma (ccRCC, first-, second- and third-line); - metastatic castration-resistant prostate cancer (mCRPC, second-line post NHT); - urothelial carcinoma (UC) ICI naïve and ICI-experienced; - non-clear cell renal (nccRCC, first-line) cell carcinoma; - Colorectal cancer (CRC); - Hepatocellular cancer (HCC); - Non-small cell lung caner (NSCLC); - Head and Neck Squamous Cell Carcinoma (HNSCC)
Product: XL092, XL092, XL092, OPDIVO 10 mg/mL concentrate for solution for infusion., Relatlimab + Nivolumab Fixed Dose Combination (FDC), Ipilimumab, XL092

Primary endpoint: Dose-Escalation Stage (Zanzalintinib Combination Therapy): -Incidence and severity of AEs and serious adverse events (SAEs), including immune-mediated adverse events (imAEs), Expansion Stage ( Zanzalintinib Monotherapy and Combination Therapy): -Objective Response Rate (ORR) in participants with measurable disease as assessed by the Investigator per RECIST 1.1, -For Cohort 3 (mCRPC): duration of radiographic PFS as determined per Prostate Working Group 3 (PCWG3) criteria (Scher et al 2016) by Blinded Independent Radiology Committee (BIRC), - For Cohort 10 (CRC): Overall survival (OS) rate at 6 months., - Incidence and severity of nonserious AEs and SAEs, including imAEs
Endpoint(s): Expansion Stage (Zanzalintinib Monotherapy and Combination Therapy): • DOR based on assessment by the Investigator per RECIST 1.1, • PFS for subjects with measurable disease as assessed by the Investigator per RECIST 1.1, • For Cohort 3 (mCRPC): o Proportion of subjects achieving a > 50% decrease in prostate-specific antigen (PSA) from baseline confirmed by a second consecutive PSA assessment at least 3 weeks later o Change in bone biomarkers - Duration of radiographic PFS as determined by Investigator per PCWG3 criteria (Scher et al 2016), • ORR, DOR, and PFS for subjects with measurable disease as assessed by a BIRC per RECIST 1.1 for selected cohorts as determined by the Sponsor, • Overall survival (OS), • Concentration of study treatments (zanzalintinib, nivolumab, ipilimumab and relatlimab) in plasma or serum at different timepoints, • Change in tumor and blood biomarkers, • The number and percentage of subjects who develop ADA response to nivolumab, ipilimumab or relatlimab

Source: https://euclinicaltrials.eu/ctis-public/view/2023-510061-10-00